EU clinical trial 2025-522187-32-01: Assessing residual inflammation and macrophage presence in lupus nephritis after 3 months of intensified treatment with prednisolone, mycofenolate mofetil and voclosporin as compared to mycofenolate mofetil and prednisolone: an open label randomized controlled trial (MAPLE study)
Sponsor: Amsterdam UMC Stichting (Patient organisation/association). Phase: Therapeutic use (Phase IV). Countries: Netherlands (ongoing, recruiting).
Therapeutic area(s): Diseases [C] - Immune System Diseases [C20]
Gender: Female, Male. Age: 0-17 years, 18-64 years, 65+ years. Enrolment: 55.
Status: Ongoing, recruiting. Start date (EU): 2026-04-23. Decision date: 2025-12-15. Results received: No. Last updated: 2026-03-17.

Condition(s): Lupus Nephritis
Product: Lupkynis 7.9 mg soft capsules

Primary endpoint: Objective 1a: to determine scRNA-seq differences within the full macrophage spectrum between arm 1 vs arm 2; the macrophage spectrum will be compared between baseline kidney biopsy and kidney biopsy at 3 months treatment
Endpoint(s): Objective 2a. numerically distinguish residential macrophages and monocyte-derived macrophages in kidney tissue with spatial scRNAseq, comparing arm 1 vs arm 2;, Objective 2b: to assess histological response of intensified treatment (arm 1) compared to SOC (arm 2);, Objective 3: to assess if early histological response is associated with clinical remission after two years and identify innovative early response determinants (including tissue monocyte/macrophage phenotyping), Objective 4: to identify differences between LN, SLE and healthy subjects in peripheral monocyte phenotype by using bulk RNA sequencing and flowcytometric analyses, to be associated with scRNAseq data and clinical/biochemical parameters. To identify potential non-invasive urinary biomarkers of disease activity in the scRNA-seq data, to be tested in sequentially stored urine and/or serum from patients, Objective 5: attempt to render (repeat) kidney biopsy in LN obsolete by identifying reliable serum and/or urinary biomarkers that reflect tissue damage and treatment response;, Objective 6: confirm scRNA-seq identified macrophage markers immunohistochemically, identify spatial distribution (glomerular vs interstitial) and assess their predictive and prognostic use., Objective 1b: analyze rapid clinical remission of intensified treatment by proteinuria levels

Source: https://euclinicaltrials.eu/ctis-public/view/2025-522187-32-01